EU clinical trial 2022-501970-20-01: A Phase 3, Randomized, Double-blind Study to Evaluate Perioperative Pembrolizumab (MK-3475) + Neoadjuvant Chemotherapy versus Perioperative Placebo + Neoadjuvant Chemotherapy in Cisplatin-eligible Participants with Muscle-invasive Bladder Cancer (KEYNOTE-866)
Protocol code: MK-3475-866
Sponsor: Merck Sharp & Dohme LLC (Pharmaceutical company). Phase: Therapeutic confirmatory (Phase III). Countries: Hungary (ended), Belgium (ended), Germany (ended), Sweden (ended), Spain (ended), France (ended), Denmark (ended), Ireland (ended), Italy (ended), Poland (ended).
Therapeutic area(s): Diseases [C] - Neoplasms [C04]
Gender: Female, Male. Age: 18-64 years, 65+ years. Enrolment: 424.
Status: Ended. Start date (EU): 2019-06-07. End date (EU): 2026-05-13. End date: 2026-05-19. Decision date: 2024-01-08. Results received: No. Last updated: 2026-05-08.
Decision dates by country: SE: 2024-01-10, DK: 2024-01-08, PL: 2024-02-05, ES: 2024-01-10, IE: 2024-01-08, DE: 2024-01-09, HU: 2024-01-11, IT: 2024-02-05, FR: 2024-01-11, BE: 2024-01-12

Condition(s): Cis-eligible Muscle-invasive bladder cancer.
Product: Placebo to Keytruda - Normal Saline Solution, GEMCITABINE, CISPLATIN, KEYTRUDA 25 mg/mL concentrate for solution for infusion

Primary endpoint: Event-Free Survival (EFS)
Endpoint(s): Pathologic Complete Response (pCR) Rate, Overall Survival (OS), Disease-Free Survival (DFS), Pathologic Downstaging (pDS) Rate, Number of Participants Who Experienced an Adverse Event (AE), Number of Participants Who Discontinued Study Treatment Due to an AE, Number of Participants Who Experienced Perioperative Complications, Change in Patient-Reported Outcomes from Baseline in the Total Score of Functional Assessment of Cancer Therapy – General (FACT-G), Change in Patient-Reported Outcomes from Baseline in the Total Score of FACT-Bladder- (FACT-BI-Cys), Change in Patient-Reported Outcomes from Baseline in FACT-BI-Cys-Trial Outcome Index (TOI), Change in Patient-Reported Outcomes from Baseline in European Quality of Life Questionnaire (EQ-5D-5L) Visual Analog Score (VAS), Time to Deterioration (TTD) in the Total Score of FACT-G, TTD in EQ-5D-5L VAS

Source: https://euclinicaltrials.eu/ctis-public/view/2022-501970-20-01